EU clinical trial 2023-507794-17-00: An Open-Label Study with Extension Phase to Evaluate the Efficacy and Safety of Perampanel Administered as an Adjunctive Therapy in Pediatric Subjects (Age 1 Month to Less Than 18 Years) With Childhood Epilepsy
Protocol code: E2007-G000-236
Sponsor: Eisai Limited (Pharmaceutical company). Phase: Therapeutic exploratory (Phase II). Countries: Germany (ended), Belgium (ongoing, recruitment ended), Spain (ongoing, recruitment ended), France (ongoing, recruitment ended).
Therapeutic area(s): Diseases [C] - Nervous System Diseases [C10]
Gender: Female, Male. Age: 0-17 years. Enrolment: 54.
Start date (EU): 2019-11-11. Decision date: 2024-05-06. Results received: No. Last updated: 2026-07-02.
Decision dates by country: BE: 2024-05-06, FR: 2024-06-12, DE: 2024-05-10, ES: 2024-05-06

Condition(s): Childhood Epilepsy
Product: Fycompa 2 mg film-coated tablets, Fycompa 2 mg film-coated tablets, Fycompa 2 mg film-coated tablets, Fycompa 0.5 mg/ml oral suspension

Primary endpoint: Proportion of 50% responders for all seizures during the Maintenance Period of Core Study.
Endpoint(s): Proportion of 50% responders for all seizures during Treatment Period of Core Study and Extension A (revised per Amendment 02)., Proportion of 25% and 75% responders for all seizures during Maintenance Period of Core Study and during Treatment Period of Core Study and Extension A, Proportion of subjects who are seizure-free during the Maintenance Period of Core Study and during the Treatment Period of Core Study and Extension A, Absolute and percent change from baseline in seizure frequency for all seizures during the Treatment Period of Core Study and during the Treatment Period of Core Study and Extension A, CGIC (Investigator Based) at the end of the Treatment Period of Core Study and at the end of Extension A, SGIC (Subject Based) at the end of the Treatment Period of Core Study and at the end of Extension A, Change from baseline in CDR parameters at the end of the Treatment Period of Core Study and at the end of Extension A (revised per Amendment 02), Change from baseline in CBCL parameters at the end of the Treatment Period of Core Study and at the end of Extension A (revised per Amendment 02), Change from baseline in LGPT parameters at the end of the Treatment Period of Core Study and at the end of Extension A (revised per Amendment 02), Changes from baseline in growth and development parameters (height, weight, thyroid, IGF-1, and sexual maturation assessed by Tanner Staging) during Treatment Period of Core Study and Extension A (revised per Amendment 02), Proportion of subjects with any treatment-emergent reports of suicidal ideation and behavior on the C-SSRS and intensity of these behaviors assessed using C-SSRS scores during Treatment Period of Core Study, Extension A, and Extension B (revised per Amendment 02), Change from baseline in number of seizures recorded on EEG at the end of the Treatment Period of Core Study and at the end of Extension A, Safety and tolerability, which include incidence of TEAEs and serious AEs (SAEs), laboratory parameters, vital signs, and ECG parameters during Treatment Period of Core Study, Extension A, and Extension B (revised per Amendment 02)

Source: https://euclinicaltrials.eu/ctis-public/view/2023-507794-17-00